EU clinical trial 2022-501854-12-01: KISIMA-02 vaccine-based immunotherapy for patients with pancreatic cancer
Protocol code: KISIMA-02
Sponsor: Boehringer Ingelheim International GmbH (Pharmaceutical company). Phase: Human Pharmacology (Phase I)- First administration to humans. Countries: France (ended), Spain (ended), Germany (ended).
Therapeutic area(s): Diseases [C] - Neoplasms [C04]
Gender: Female, Male. Age: 18-64 years, 65+ years. Enrolment: 37.
Status: Ended. Start date (EU): 2025-02-05. End date (EU): 2026-07-02. Decision date: 2024-04-04. Results received: No. Last updated: 2026-06-10.
Decision dates by country: FR: 2024-04-04, ES: 2024-04-05, DE: 2024-04-08

Condition(s): G12D/G12V Pancreatic Ductal Adenocarcinoma

Source: https://euclinicaltrials.eu/ctis-public/view/2022-501854-12-01